EU clinical trial 2024-512189-33-00: A Phase IIb, prospective, intra-patient randomised controlled, multicentre study to evaluate the safety and efficacy of an autologous bio-engineered dermo-epidermal skin substitute (EHSG-KF) for the treatment of partial deep dermal and full thickness burns in children in comparison to autologous split-thickness skin grafts (STSG) (BC)
Protocol code: TBRU-dS-BC-PIIb
Sponsor: Cutiss AG (Pharmaceutical company). Phase: Therapeutic exploratory (Phase II). Countries: Italy (ongoing, recruitment ended), Netherlands (ended).
Therapeutic area(s): Diseases [C] - Skin and Connective Tissue Diseases [C17]
Gender: Female, Male. Age: 0-17 years. Enrolment: 8.
Start date (EU): 2019-01-14. Decision date: 2024-10-21. Results received: No. Last updated: 2026-06-25.
Decision dates by country: NL: 2024-10-21, IT: 2024-10-28

Condition(s): Children with partial deep dermal and full thickness burns
Product: EHSG-KF

Primary endpoint: Efficacy evaluation, as a comparison between the EHSG-KF and control sites, based on: - Ratio of covered surface area to biopsy site/donor site surface area at: - visit 6 (28 ± 3 days post grafting)
Endpoint(s): % Epithelialization at: - visit 8 (90 ± 5 days post grafting), Safety and efficacy evaluation, as a comparison between the EHSG-KF and control sites, based on: see point 3 - 6, Main secondary safety endpoint: Clinical and microbiologic signs of infection at: o visit 4 (6-10 days post grafting) o visit 5 (21 ± 2 days post grafting), Main secondary efficacy endpoints: Scar quality at the study areas o Assessment of elasticity of the study areas using the Cutometer® at visit 10 (1 year ± 30 days post grafting) o Assessment of general scar quality at the study areas using the POSAS, a reliable and validated scar assessment tool, at visit 10 (1 year ± 30 days post grafting), Other secondary safety endpoint: Assessment and reporting of all observed adverse events will be carried out for the full duration of the study from visit 2 on., Other secondary efficacy endpoint: Epithelialization at: o visit 6 (28 ± 3 days post grafting)

Source: https://euclinicaltrials.eu/ctis-public/view/2024-512189-33-00